EU clinical trial 2023-503490-38-00: Intravenous Fish Oil based Lipid Emulsion to enhance recovery in High-Risk Cardiac Surgery Patients: a phase II multicenter trial
Protocol code: MODIFY CSX
Sponsor: Gcp-Service International West GmbH (Pharmaceutical company). Phase: Therapeutic exploratory (Phase II). Countries: Germany (ongoing, recruiting).
Therapeutic area(s): Diseases [C] - Cardiovascular Diseases [C14]
Gender: Female, Male. Age: 18-64 years, 65+ years. Enrolment: 378.
Status: Ongoing, recruiting. Start date (EU): 2023-11-15. Decision date: 2023-08-15. Results received: No. Last updated: 2026-04-20.

Condition(s): critical illness, intensive care unit (ICU), surgery
Product: Omegaven-Fresenius Emulsion zur Infusion, 0,9% NaCl

Primary endpoint: AFACS, incorporating atrial fibrillation, atrial flutter and atrial tachycardia, until 7 days after surgery
Endpoint(s): Time to hospital discharge alive (TDA), Days alive and out of hospital within 30 days, Number of attempts to wean from CPB during surgery, Persistent Organ Dysfunction (POD) + Death within 30 days, Time to ICU discharge alive, ICU and Hospital Readmission rates, Delta Sequential Organ Failure Assessment (SOFA) Score, Duration of mechanical ventilation (invasive and non-invasive), Incidence of stroke, Duration of inotropic/vasopressor/mechanical support, Acute Kidney Injury (by Kidney Disease: Improving Global Outcomes [KDIGO] stages 1-3), Number of infections, Overall survival, Physical activity (Katz activities of daily living (ADL) and Lawton Instrumental ADL (IADL), Quality of Life (Short Form-36 [SF-36]), Postoperative bleeding, Adverse events (AEs) leading to discontinuation/AEs at least possibly related to the IMP/Serious adverse events (SAEs)

Source: https://euclinicaltrials.eu/ctis-public/view/2023-503490-38-00